EU clinical trial 2024-511038-11-00: A Phase 2, randomized, open-label, dose-finding study of Debio 4228, an extended-release formulation of gonadotropin-releasing hormone antagonist in participants with advanced prostate cancer
Protocol code: Debio 4228-201
Sponsor: Debiopharm International SA (Pharmaceutical company). Phase: Therapeutic exploratory (Phase II). Countries: France (ended), Belgium (ended), Spain (ended), Poland (ended), Bulgaria (ended), Italy (ended), Lithuania (ended).
Therapeutic area(s): Diseases [C] - Neoplasms [C04]; Diseases [C] - Male Urogenital Diseases [C12]
Gender: Male. Age: 18-64 years, 65+ years. Enrolment: 41.
Status: Ended. Start date (EU): 2024-09-24. End date (EU): 2026-07-22. End date: 2026-07-23. Decision date: 2024-07-17. Results received: No. Last updated: 2026-07-02.
Decision dates by country: ES: 2024-08-13, BE: 2024-08-09, FR: 2024-08-09, PL: 2025-11-21, BG: 2025-11-24, IT: 2025-11-24, LT: 2025-10-31

Condition(s): advanced prostate cancer
Product: Debio 4228, Debio 4228

Primary endpoint: Degarelix plasma PK profile and PK parameters over 12 weeks after Debio 4228 dosing, including but not limited to: - Maximum concentration (Cmax) - Area under the concentration-time curve over 12 weeks (AUC84d) - Concentration at 12 weeks (C84d) This will be derived for each treatment period., Testosterone serum concentration profile from Day 1 to Day 85 for all cohorts and from Day 85 to Day 169 in case of Cohort 3
Endpoint(s): Achievement and maintenance of testosterone castration (testosterone level <50 ng/dL and <20 ng/dL) from Day 29 to Day 85 for all cohorts, Maintenance of testosterone castration (testosterone level <50 ng/dL and <20 ng/dL) from Day 29 to Day 169 for Cohort 3, Time to castration (testosterone level <50 ng/dL and <20 ng/dL), Investigator’s assessment (4-point rating scale) of erythema, swelling, and induration at the injection site immediately after Debio 4228 injection, 2 hours, and 24 hours (Day 2) after Debio 4228 injection, Participants’ self-assessment of pain at the injection site immediately after Debio 4228 injection, 2 hours, and 24 hours (Day 2) after Debio 4228 injection using Numeric Pain Rating Scale (NPRS), Incidence and severity of treatment-emergent adverse events (TEAEs), related TEAEs, serious TEAEs, adverse events of special interest (AESIs), death, and TEAEs leading to treatment delay, and/or discontinuation, graded according to National Cancer Institute Common Terminology Criteria for Adverse Events (NCI-CTCAE) version 5.0;, Percentage of change of PSA over time (per scheduled timepoint), Time course of changes of LH and FSH (per scheduled timepoint), Safety laboratory parameters and related severity based on NCI-CTCAE version 5.0, Changes from baseline in vital signs, weight, and electrocardiogram (ECG)

Source: https://euclinicaltrials.eu/ctis-public/view/2024-511038-11-00